EU clinical trial 2026-525382-47-00: A Phase 2 Study of Alisertib in Combination with Paclitaxel in Patients with Small Cell Lung Cancer
Protocol code: PUMA-ALI-4202
Sponsor: Puma Biotechnology Inc. (Pharmaceutical company). Phase: Therapeutic exploratory (Phase II). Countries: France (authorised, recruitment pending), Poland (authorised, recruitment pending), Spain (authorised, recruitment pending).
Therapeutic area(s): Diseases [C] - Neoplasms [C04]
Gender: Female, Male. Age: 18-64 years, 65+ years. Enrolment: 30.
Status: Authorised, recruitment pending. Decision date: 2026-07-28. Results received: No. Last updated: 2026-08-04.
Decision dates by country: FR: 2026-07-28, ES: 2026-07-28, PL: 2026-08-03

Condition(s): Small Cell Lung Cancer (SCLC)
Product: Paclitaxel AqVida 6 mg/ml Konzentrat zur Herstellung einer Infusionslösung, Alisertib Enteric-Coated Tablets

Primary endpoint: Adverse Events (AEs) and serious adverse events (SAEs) per National Cancer Institute Common Terminology Criteria for Adverse Events Version 5.0 (NCI CTCAE v5.0)
Endpoint(s): Objective response rate (ORR), duration of response (DOR), disease control rate (DCR), progression-free survival (PFS), and overall survival (OS).

Source: https://euclinicaltrials.eu/ctis-public/view/2026-525382-47-00